EU clinical trial 2025-521113-13-00: A Phase 2/3, Double-Blind, Placebo-Controlled Study of BHV-8000 in Participants with Early Parkinson’s Disease
Protocol code: BHV8000-301
Sponsor: Biohaven Therapeutics Ltd. (Pharmaceutical company). Phase: Phase II and Phase III (Integrated). Countries: Germany (authorised, recruitment pending), France (authorised, recruitment pending), Italy (authorised, recruitment pending), Belgium (authorised, recruitment pending), Czechia (authorised, recruitment pending), Poland (authorised, recruitment pending), Austria (authorised, recruitment pending), Netherlands (authorised, recruitment pending), Spain (authorised, recruitment pending), Portugal (authorised, recruitment pending).
Therapeutic area(s): Diseases [C] - Nervous System Diseases [C10]
Gender: Female, Male. Age: 18-64 years, 65+ years. Enrolment: 713.
Status: Authorised, recruitment pending. Decision date: 2025-12-15. Results received: No. Last updated: 2025-12-22.
Decision dates by country: AT: 2025-12-22, BE: 2025-12-15, CZ: 2025-12-15, FR: 2025-12-22, DE: 2025-12-16, IT: 2025-12-16, PT: 2025-12-15, ES: 2025-12-22, NL: 2025-12-17, PL: 2025-12-22

Condition(s): Early Parkinson’s Disease
Product: BHV-8000, DaTSCAN 74 MBq/ml solution for injection, DaTSCAN 74 MBq/ml solution for injection, BHV-8000, Placebo for BHV-8000

Primary endpoint: Time to first qualifying worsening event on Movement Disorder Society-Unified Parkinson's Disease Rating Scale (MDS-UPDRS) Part II [Time Frame: Up to 48 Weeks]. To evaluate the efficacy of BHV-8000 compared to placebo. This objective is measured by assessing the time to prespecified worsening on MDS-UPDRS Part II (motor experiences of daily living per self-administered questionnaire). MDS-UPDRS Part II is a 52-point scale with a higher total score representing more severe disability.
Endpoint(s): Change in Movement Disorder Society-Unified Parkinson's Disease Rating Scale (MDS-UPDRS) Part III from Baseline to Week 48 [Time Frame: Baseline to Week 48]. This objective is measured by assessing the change in MDS-UPDRS Part III (motor examination conducted by rater). MDS-UPDRS Part III is a 132-point scale with a higher total score representing a greater degree of motor impairment., Change in Clinical Global Impression of Severity (CGI-S) from Baseline to Week 48 [Time Frame: Baseline to Week 48]. To evaluate the efficacy of BHV-8000 compared to placebo. This objective is measured by assessing the change in severity of a participant's illness as determined by the managing clinician. The CGI-S is a 7-point scale (1 - 7) with 7 representing the most extremely ill participants., Change in DaT-SPECT scan from Baseline to Week 48 [Time Frame: Baseline to Week 48]. To evaluate the efficacy of BHV-8000 compared to placebo. This objective is measured by change in DaT-SPECT Striatal Binding Ratio (SBR) in the putamen (assessing the activity of the dopamine transporters). Reduced uptake of the radiotracer is indicative of a decreased number of dopamine-secreting cells and suggestive of disease progression., Change in Parkinson's Disease Composite Score - Function (PARCOMS-Function) from Baseline to Week 48 [Time Frame: Baseline to Week 48].To compare the efficacy of BHV-8000 compared to placebo.This objective is measured by changes in the Parkinson's Disease Composite Score-Function (PARCOMS-Function) score.The PARCOMS-Function is a composite of select items taken from the MDS-UPDRS Part II and the PDQ-39. The PARCOMS-Function is a 100-point scale with higher scores representing greater disfunction, Number of Participants with Deaths, Serious AEs (SAEs), AEs Leading to Study Drug Discontinuation, and moderate or severe AEs [Time Frame: Baseline to Week 48]. To assess the safety and tolerability of BHV-8000. This objective will be measured by assessing the number of unique participants with deaths, SAEs, AEs leading to discontinuation, and moderate and severe AEs., Number of participants with clinically significant laboratory abnormalities [Time Frame: Baseline to Week 48]. To assess the safety and tolerability of BHV-8000. This objective will be measured by assessing the number of unique participants with treatment-emergent Grade 3 and 4 laboratory abnormalities.

Source: https://euclinicaltrials.eu/ctis-public/view/2025-521113-13-00